EU clinical trial 2024-512191-35-00: Brachial plexus nerve block versus haematoma block for closed reduction of distal radius fracture in adults – The BLOCK Trial
Sponsor: Region Hovedstaden (Hospital/Clinic/Other health care facility). Phase: Therapeutic use (Phase IV). Countries: Denmark (ongoing, recruiting).
Therapeutic area(s): Diseases [C] - Musculoskeletal Diseases [C05]; Analytical, Diagnostic and Therapeutic Techniques and Equipment [E] - Anesthesia and Analgesia [E03]
Gender: Female, Male. Age: 18-64 years, 65+ years. Enrolment: 1716.
Status: Ongoing, recruiting. Start date (EU): 2024-12-10. Decision date: 2024-09-12. Results received: No. Last updated: 2026-06-18.

Condition(s): Distal radius fracture in need of acute closed reduction
Product: Lidokain-adrenalin SAD, injektionsvæske, opløsning

Primary endpoint: Cumulative proportion of patients with distal radius fracture surgery 90 days after closed reduction
Endpoint(s): Composite outcome of treatment related complications: loco-regional neurological complications from affected arm, local anaesthetic systemic toxicity, soft tissue injuries related to the closed reduction procedure, infection at the site of needle puncture, vessel puncture requiring subsequent treatment, pneumothorax, allergic reaction, new bone or joint injury after the closed reduction and/or pulmonary embolism witin 90 days after closed reducti, Patient Rated Wrist Evaluation (PRWE) 90 days after closed reduction, Maximum pain score (Numerical Rating Scale (NRS) 0-10) in the affected wrist during closed reduction(s), Proportion of patients with unacceptable radiographic fracture position immediately after closed reduction, according to AAOS guidelines

Source: https://euclinicaltrials.eu/ctis-public/view/2024-512191-35-00